EU clinical trial 2022-502595-23-00: A Phase 1/2 Study of TAS3351 in Patients with Advanced Non-Small Cell Lung Cancer and EGFR Mutations
Protocol code: 10073010
Sponsor: Taiho Oncology Inc. (Pharmaceutical company). Phase: Phase I and Phase II (Integrated)- First administration to humans. Countries: France (ended), Netherlands (ended), Germany (ended), Spain (ended), Italy (ended).
Therapeutic area(s): Diseases [C] - Respiratory Tract Diseases [C08]
Gender: Female, Male. Age: 18-64 years, 65+ years. Enrolment: 35.
Status: Ended. Start date (EU): 2024-05-21. End date (EU): 2025-04-17. End date: 2025-04-18. Decision date: 2023-07-05. Results received: Yes. Last updated: 2024-08-21.
Decision dates by country: NL: 2023-07-26, ES: 2023-10-26, DE: 2023-07-05, FR: 2023-07-10, IT: 2023-11-14

Condition(s): Patients with locally advanced or metastatic non-small cell lung cancer (NSCLC) harboring an acquired C797S epidermal growth factor receptor (EGFR) mutation.
Product: TAS3351, TAS3351, TAS3351

Primary endpoint: Phase 1 Dose Escalation • Safety, including (but not limited to) AEs graded by CTCAE v5.0, and incidence of dose limiting toxicities (DLTs). As supplementary data, preliminary antitumor activity and PK/PD results will be considered., Phase 1 Dose Expansion • ORR per RECIST v1.1 by independent central review (ICR), Phase 2 • ORR per RECIST v1.1 by ICR
Endpoint(s): Phase 1 Dose Escalation • Objective response rate (ORR) per Response Evaluation Criteria in Solid Tumors (RECIST) v1.1 by Investigator • Duration of response (DoR), disease control rate (DCR), and time on treatment • Progression free survival and OS (Patients in part A2 only) • PK parameters including but not limited to maximum plasma concentration (Cmax), time to maximum plasma concentration (Tmax), area under the plasma concentration-time curve (AUC), and terminal elimination halflife (T½), Phase 1 Dose Expansion • AEs, including SAEs, clinical laboratory tests, vital signs, and 12-lead ECGs graded according to CTCAE v5.0 • DoR, PFS, and DCR by ICR • ORR, DoR, PFS, and DCR by Investigator assessment. • Overall survival (OS), Phase 2 • DoR, PFS, and DCR by ICR • ORR, DoR, PFS, and DCR by Investigator assessment • Overall survival (OS) • AEs, including SAEs, clinical laboratory tests, vital signs, and 12-lead ECGs graded according to CTCAE v5.0 • EORTC QLQ-C30 and EQ-5D-5L

Source: https://euclinicaltrials.eu/ctis-public/view/2022-502595-23-00